EU clinical trial 2024-517254-99-00: IMMUNORARE5 : A national platform of 5 academic phase II trials coordinated by Lyon university hospital to assess the safety and the efficacy of the IMMUNOtherapy with Domvanalimab + Zimberelimab combination in patients with advanced RARE cancers
Protocol code: 69HCL24_0656
Sponsor: Hospices Civils De Lyon (Hospital/Clinic/Other health care facility). Phase: Therapeutic exploratory (Phase II). Countries: France (temporarily halted).
Therapeutic area(s): Diseases [C] - Neoplasms [C04]
Gender: Female, Male. Age: 18-64 years, 65+ years. Enrolment: 186.
Status: Temporarily halted. Start date (EU): 2025-09-16. Decision date: 2025-06-02. Results received: No. Last updated: 2026-01-07.

Condition(s): The patients enrolled in IMMUNORARE will be adult patients with 5 rare cancers: -Cohort 1: Peritoneal mesotheliomas (PM); -Cohort 2: Gestational trophoblastic tumors (GTT); -Cohort 3: B3 thymomas and thymic carcinomas (TET); -Cohort 4: Anaplastic thyroid carcinomas (ATC); -Cohort 5: GEP-NET & carcinoid tumors (GEP-NET/TCT/UP-NET); Patients will have advanced/metastatic cancers found to be progressive/resistant after at least one previous line of standard systemic treatment.
Product: FOLINATE DE CALCIUM KALCEKS 10 mg/mL, solution injectable/pour perfusion, OXALIPLATINE KABI 5 mg/ml, solution à diluer pour perfusion., FLUOROURACILE PFIZER 50 mg/mL, solution à diluer pour perfusion, DOMVANALIMAB, Zimberelimab

Primary endpoint: The primary endpoint will be assessed 24 weeks after the start of study treatment. It will be different across the different cohorts to take into account their prognosis specificities: Cohort 1 = Progression free survival rate at 24 weeks; Cohort 2 = Successful hCG normalization rate at 24 weeks ; Cohort 3 = Progression free survival rate at 24 weeks; Cohort 4 = Survival rate at 24 weeks; Cohort 5 = Progression free survival rate at 24 weeks
Endpoint(s): Overall response rate defined as the proportion of patients experiencing complete or partial radiological response as the best radiological tumor response on the study period according to RECIST 1.1 for cohorts 3-5 and mRECIST for cohort 1., Progression-free survival (PFS) defined as the time elapsed between inclusion and disease progression/death whichever occurs first, according to RECIST criteria (cohorts 3-5) or according to mRECIST criteria (cohort 1). Patients alive without progression will be censored at the last date of imaging assessment., Resistance-free survival (RFS) calculated as the time elapsed between inclusion and disease resistance defined as the date of subsequent treatment start for lack of efficacy of study treatment (cohort 2). Patients without resistance will be censored at the date of last news., Overall survival (cohorts 1-3 and 5) defined as the time elapsed between inclusion and patients death regardless of the cause. Patients alive will be censored at the last date of last news., Duration of response (cohorts 1, 3-5): delay between overall response and progression or death whichever occurs first, Adverse events and grades according to NCI-CTCAE v 5 criteria., Exploratory study TROPHOGEN - Primary endpoint : Proportion of patients experiencing a successful hCG-normalization within 24 weeks while on study treatment (%), according to deregulations of the immune signaling pathways and to somatic molecular anomalies, Exploratory study TROPHOGEN - secondary endpoint 1 : Resistance-free survival (RFS) calculated as the time elapsed between inclusion and disease resistance defined as the date of subsequent treatment start for lack of efficacy of study treatment, according to the deregulations of the immune signaling pathways and to somatic molecular anomalies, Exploratory study TROPHOGEN - secondary endpoint 2 : Overall survival defined as the time elapsed between inclusion and patient’s death regardless of the cause, according to the deregulations of the immune signaling pathways and to somatic molecular anomalies. Patients alive will be censored at the last date of last news. Patients without resistance will be censored at the date of last news., Exploratory study TROPHOGEN - secondary endpoint 3 : Adverse events and grades according to NCI-CTCAE v 5 criteria, PFS-post initial progression (PFS-PIP), defined as the time elapsed between inclusion and the 2nd progression or death (whichever occurs first) following an initial disease progression, according to RECIST criteria (cohorts 3-5) or according to mRECIST criteria (cohort 1), for patients who continued the treatment after an initial disease progression upon investigator discretion. Patients alive without this 2nd progression will be censored at the last date of imaging assessment

Source: https://euclinicaltrials.eu/ctis-public/view/2024-517254-99-00